EU clinical trial 2024-514725-38-00: A randomized, single dose, cross-over, replicated, open-label bioequivalence study comparing indacaterol/glycopyrronium (85/43mcg inhalation powder hard capsules) (PG341 [Celon Pharma] vs Ultibro Breezhaler [Novartis])
Protocol code: 01INDA2024
Sponsor: Celon Pharma S.A. (Pharmaceutical company). Phase: Human Pharmacology (Phase I)- Bioequivalence Study. Countries: Poland (ended).
Therapeutic area(s): Diseases [C] - Respiratory Tract Diseases [C08]
Gender: Female, Male. Age: 18-64 years. Enrolment: 40.
Status: Ended. Start date (EU): 2025-05-26. End date (EU): 2025-09-01. Decision date: 2024-11-18. Results received: No. Last updated: 2025-09-15.

Condition(s): Maintenance bronchodilator treatment to relieve symptoms in adult patients with chronic obstructive pulmonary disease (COPD)

Source: https://euclinicaltrials.eu/ctis-public/view/2024-514725-38-00